EU clinical trial 2023-506753-38-00: Gut microbiome intervention with EXL01 in combination with nivolumab and FOLFOX as first-line treatment for patients with PD-L1 CPS ≥5 metastatic gastric cancer: A randomized GERCOR phase II study (BIG)
Protocol code: BIG G-122
Sponsor: Gercor (Pharmaceutical company). Phase: Therapeutic exploratory (Phase II). Countries: France (ongoing, recruiting).
Therapeutic area(s): Diseases [C] - Digestive System Diseases [C06]
Gender: Female, Male. Age: 18-64 years, 65+ years. Enrolment: 120.
Status: Ongoing, recruiting. Start date (EU): 2024-04-16. Decision date: 2024-01-26. Results received: No. Last updated: 2026-06-03.

Condition(s): metastatic gastric adenocarcinoma
Product: OPDIVO 10 mg/mL concentrate for solution for infusion., CALCIUM FOLINATE, FLUOROURACIL SODIUM, OXALIPLATINE ACCORD 5 mg/ml, solution à diluer pour perfusion, EXL01

Primary endpoint: ORR at 4 months of patients with PD-L1 CPS ≥5 advanced gastric cancer treated by EXL01 plus nivolumab and FOLFOX as first-line treatment, investigator review according to RECIST v1.1 .
Endpoint(s): Safety of nivolumab plus FOLFOX with or without EXL01, PFS per RECIST v 1.1 and iRECIST criteria in patients receiving nivolumab plus FOLFOX with or without EXL01,assessed by investigator review., 1-year and 2-year PFS of patients receiving nivolumab plus FOLFOX with or without EXL01,assessed by investigator review., OS of patients receiving nivolumab plus FOLFOX with or without EXL01,, 2-year and 3-year OS of patients receiving nivolumab plus FOLFOX with or without EXL01,, ORR per RECIST v 1.1 criteria in patients receiving nivolumab plus FOLFOX with or without EXL01, assessed by investigator review., DoR in patients receiving nivolumab plus FOLFOX with or without EXL01., Percentage of patients with shifts, on treatment versus baseline, in peripheral blood and serum markers as T cell subpopulations, MDSCs, and changes in immune related markers., Association between immunogenicity of EXL01 and efficacy, and safety, outcome parameters., Biomarkers associated with clinical efficacy (OS, PFS, and ORR) and/or incidence of adverse events (AEs) of nivolumab plus FOLFOX with or without EXL01 by analyzing biomarker measures within the tumor microenvironment (e.g., PD-L1 CPS microsatellite instability, circulating tumor DNA) and periphery (e.g., blood, stool) in comparison to clinical outcomes,, The impact of nivolumab plus FOLFOX with or without EXL01 on gut microbiota composition., The impact of previous gastrectomy on the efficacy and tolerability of nivolumab plus FOLFOX with or without EXL01., 6.7. ORR by blinded independent central review (BICR) per RECIST v 1.1 criteria,

Source: https://euclinicaltrials.eu/ctis-public/view/2023-506753-38-00